EU clinical trial 2024-517002-28-01: Phase I-Ib clinical trial of safety and immunobiology of prophylactic infusion of lymphocytes and NK cells after Allo-HCT.
Sponsor: Vall D Hebron Institute Of Oncology (Laboratory/Research/Testing facility). Phase: Human Pharmacology (Phase I)- Other. Countries: Spain (ongoing, recruiting).
Therapeutic area(s): Diseases [C] - Virus Diseases [C02]; Diseases [C] - Neoplasms [C04]; Diseases [C] - Bacterial Infections and Mycoses [C01]
Gender: Female, Male. Age: 18-64 years, 65+ years. Enrolment: 8.
Status: Ongoing, recruiting. Start date (EU): 2025-12-17. Decision date: 2025-06-27. Results received: No. Last updated: 2026-06-09.

Condition(s): graft-versus-host disease

Source: https://euclinicaltrials.eu/ctis-public/view/2024-517002-28-01